EU clinical trial 2024-513437-21-00: The Effect of Cancer Treatments on Speech Perception in Noise, Cognition, and Quality of Life
Sponsor: Turku University Hospital (Hospital/Clinic/Other health care facility). Phase: Therapeutic use (Phase IV). Countries: Finland (ongoing, recruiting).
Therapeutic area(s): Diseases [C] - Neoplasms [C04]
Gender: Female, Male. Age: 18-64 years, 65+ years. Enrolment: 250.
Status: Ongoing, recruiting. Start date (EU): 2024-10-02. Decision date: 2024-07-26. Results received: No. Last updated: 2024-07-26.

Condition(s): Cancer
Product: Cisplatin Accord 1 mg/ml infuusiokonsentraatti, liuosta varten, Gemcitabine Accord 100 mg/ml infuusiokonsentraatti, liuosta varten, Oxaliplatin Accord 5 mg/ml, infuusiokonsentraatti, liuosta varten., Capecitabine Orion 500 mg kalvopäällysteiset tabletit, Uromitexan cum conservans 100 mg/ml injektioneste, liuos, Holoxan injektio-/infuusiokuiva-aine, liuosta varten, Etoposide Accord 20 mg/ml Infuusiokonsentraatti, liuosta varten, Bleomycin Baxter 15 000 KY injektio-/infuusiokuiva-aine, liuosta varten

Primary endpoint: The change in speech perception in noise (measured with the Finnish matrix sentece test) from the baseline to the first follow-up visit at 3-4 months after the end the initial treatment
Endpoint(s): Long-term change in the speech perception in noise, Short- and long-term change in extended high frequency hearing, Hearing-related quality of life, Changes in Functional Assessment of Cancer Therapy - Cognitive Function questionnaire and in standardized neuropsychological tests

Source: https://euclinicaltrials.eu/ctis-public/view/2024-513437-21-00